EU clinical trial 2024-519746-70-01: A Phase 2, Double-blind, Randomized, Placebo-Controlled, Multicenter, Dose-Finding, Efficacy, and Safety Study of Tebapivat in Participants With Sickle Cell Disease
Protocol code: AG946-C-003
Sponsor: Agios Pharmaceuticals Inc. (Pharmaceutical company). Phase: Therapeutic exploratory (Phase II). Countries: Belgium (ongoing, recruitment ended), Netherlands (ongoing, recruitment ended), France (ongoing, recruitment ended), Ireland (ongoing, recruitment ended).
Therapeutic area(s): Diseases [C] - Hemic and Lymphatic Diseases [C15]
Gender: Female, Male. Age: 0-17 years, 18-64 years, 65+ years. Enrolment: 20.
Status: Ongoing, recruitment ended. Start date (EU): 2025-09-15. Decision date: 2025-07-14. Results received: No. Last updated: 2026-04-23.
Decision dates by country: FR: 2025-07-15, NL: 2025-07-14, IE: 2025-07-18, BE: 2025-07-16

Condition(s): Sickle Cell Disease
Product: Placebo for AG-946 oral tablet., AG-946, AG-946

Primary endpoint: Hb response, defined as a ≥1.0 g/dL increase in average Hb concentration from Week 10 through Week 12 compared with baseline
Endpoint(s): Type, frequency, severity, and relationship to study drug of adverse events (AEs) and serious (SAEs), Average change from baseline in Hb concentration from Week 10 through Week 12, Average change from baseline in markers of hemolysis, including indirect bilirubin and lactate dehydrogenase (LDH), from Week 10 through Week 12, Average change from baseline in markers of erythropoiesis, including absolute reticulocyte count, percent reticulocytes, and erythropoietin, from Week 10 through Week 12, Average change from baseline in Patient Reported Outcomes Measurement Information System® (PROMIS) Fatigue 13a Short Form score from Week 10 through Week 12, Average change from baseline in PROMIS Pain Intensity 1a score from Week 10 through Week 12, Average change from baseline in Adult Sickle Cell Quality of Life Measurement Information System (ASCQ-Me) Pain Impact score from Week 10 through Week 12, Plasma concentration and PK parameters of tebapivat during the Double-blind Period, Whole blood concentrations and PD parameters, including 2,3-DPG and ATP, during the Doubleblind Period, Annualized rate of SCPCs through Week 12, Change from baseline in 6MWT at Week 12, Change from baseline in the 3 Cogstate cognition tests (Identification Test, One Back Test, and Groton Maze Learning Test) at Week 12, Change from baseline in 4 WPAI scores (absenteeism, presenteeism, work productivity loss, and activity impairment) at Week 12, Change from baseline in biomarkers related to inflammation, vascular biology, and the pathogenesis of SCD at Week 8, Change from baseline in biomarkers related to iron metabolism at Week 10, Exposure-response relationship between relevant PK parameters and endpoints that are indicators of clinical activity (changes in Hb hemolysis markers and PD markers [ATP and 2,3-DPG]) and safety (including platelet counts) during the Double-blind Period, Change from baseline during the Open-label Extension (OLE) Period in: - Hb concentration - Markers of erythropoiesis and hemolysis - Patient-reported outcomes (PROs) and performance outcomes (PerfOs) - Biomarkers, AEs, SAEs, discontinuations due to AEs, and laboratory abnormalities during the OLE Period

Source: https://euclinicaltrials.eu/ctis-public/view/2024-519746-70-01